EU clinical trial 2025-524328-24-00: GRT-1C102: A randomized, double-blind, placebo-controlled dose escalation study to evaluate the safety, tolerability, and pharmacokinetics/pharmacodynamics of GRT-001 after subcutaneous administrations to healthy subjects (MONOSqut trial).
Protocol code: GRT-1C102
Sponsor: Granite Bio AG (Pharmaceutical company). Phase: Human Pharmacology (Phase I)- Other. Countries: Germany (ongoing, recruiting).
Therapeutic area(s): Diseases [C] - Digestive System Diseases [C06]
Gender: Female, Male. Age: 18-64 years. Enrolment: 40.
Status: Ongoing, recruiting. Start date (EU): 2026-05-06. Decision date: 2026-04-15. Results received: No. Last updated: 2026-07-31.

Condition(s): Ulcerative colitis

Source: https://euclinicaltrials.eu/ctis-public/view/2025-524328-24-00